EU clinical trial 2023-507644-37-00: Iodine Contrasts Effectiveness and Safety in Contrast Enhanced Mammography and breast magnetic resonance imaging.
Protocol code: DICES
Sponsor: Uniwersytet Jagiellonski Collegium Medicum (Educational Institution). Phase: Therapeutic confirmatory (Phase III). Countries: Poland (ongoing, recruiting).
Therapeutic area(s): Diseases [C] - Neoplasms [C04]
Gender: Female. Age: 18-64 years, 65+ years. Enrolment: 900.
Status: Ongoing, recruiting. Start date (EU): 2024-12-13. Decision date: 2024-05-27. Results received: No. Last updated: 2026-03-09.

Condition(s): Breast cancer

Source: https://euclinicaltrials.eu/ctis-public/view/2023-507644-37-00